EU clinical trial 2023-507296-21-00: MAMI Use of the Methoxyflurane as pain-killer in the prehospital management of Acute Myocardial Infarction
Protocol code: APHP 180610
Sponsor: Assistance Publique Hopitaux De Paris (Hospital/Clinic/Other health care facility). Phase: Therapeutic confirmatory (Phase III). Countries: France (not authorised).
Therapeutic area(s): Diseases [C] - Cardiovascular Diseases [C14]
Gender: Female, Male. Age: 18-64 years, 65+ years. Enrolment: 700.
Status: Not authorised. Decision date: 2025-06-13. Results received: No. Last updated: 2025-06-13.

Condition(s): Acute Myocardial Infarction
Product: MORPHINE, PENTHROX 99,9%, liquide pour inhalation par vapeur de 3 mL

Primary endpoint: Proportion of patients achieving pain relief, i.e. pain intensity score on visual analogic scale (VAS) ≤ 3 at 30 minutes.
Endpoint(s): Pain relief: time before achieving pain relief, i.e. time between randomization and pain intensity score on VAS ≤ 3;, Pain relief: time to reach initial pain divided by two (initial VAS / 2), Impact of the treatments on cardiovascular system: heart rate, arterial blood pressure, pulse oximetry and ECG changes at hospital arrival, Tolerance of the treatments: respiratory depression: respiratory rate < 10 cycles per minutes, Tolerance of the treatments: sedation: Richmond Agitation - Sedation Scale (RASS) ≥ 2 or ≤ -2, Tolerance of the treatments: : dizziness, pruritus, nausea, vomiting, headache

Source: https://euclinicaltrials.eu/ctis-public/view/2023-507296-21-00